EU clinical trial 2022-502597-16-00: A Phase 1/2, Open-label, Dose-escalation, Safety, Pharmacokinetic, and Pharmacodynamic Study of Oral Nuvisertib (TP-3654) in Patients with Intermediate or High-risk Primary or Secondary Myelofibrosis
Protocol code: BBI-TP-3654-102
Sponsor: Sumitomo Pharma America Inc. (Pharmaceutical company). Phase: Phase I and Phase II (Integrated)- Other. Countries: France (ongoing, recruiting), Italy (ongoing, recruiting), Belgium (ongoing, recruiting), Austria (authorised, recruitment pending), Bulgaria (authorised, recruitment pending), Czechia (authorised, recruitment pending), Denmark (authorised, recruitment pending), Germany (authorised, recruiting), Hungary (authorised, recruitment pending), Romania (authorised, recruitment pending), Spain (authorised, recruiting), Netherlands (authorised, recruitment pending), Poland (authorised, recruitment pending).
Therapeutic area(s): Diseases [C] - Neoplasms [C04]
Gender: Female, Male. Age: 18-64 years, 65+ years. Enrolment: 58.
Start date (EU): 2023-10-27. Decision date: 2023-07-04. Results received: No. Last updated: 2026-07-29.
Decision dates by country: BE: 2023-07-04, IT: 2023-07-17, AT: 2025-12-22, BG: 2026-01-05, CZ: 2026-01-08, DK: 2025-12-08, HU: 2025-11-19, RO: 2026-01-12, ES: 2026-01-02, NL: 2025-12-22, PL: 2026-01-04, FR: 2023-07-10, DE: 2025-12-10

Condition(s): Intermediate or High-risk Primary or Secondary Myelofibrosis
Product: Nuvisertib, Nuvisertib, Nuvisertib

Primary endpoint: Nuvisertib Monotherapy (Arm 1) - Phase 1: Dose-limiting toxicity (DLT) at escalated doses of Nuvisertib., Nuvisertib Monotherapy (Arm 1) - Phase 1: Adverse events (AEs) as characterized by type, frequency, severity, seriousness, and relationship to study drugs. (Note: This endopoint is secondary in Phase 2), Nuvisertib Monotherapy (Arm 1) - Phase 2: Spleen volume response: ≥35% spleen volume reduction (SVR35) at any time., Nuvisertib + Momelotinib (Arm 3) – Phase 1: Dose-limiting toxicity (DLT) at escalated doses of Nuvisertib when administered in combination with momelotinib., Nuvisertib + Momelotinib (Arm 3) – Phase 1: Adverse events (AEs) as characterized by type, frequency, severity, seriousness, and relationship to study drugs. [Note: This endpoint is secondary in Phase 2], Nuvisertib + Momelotinib (Arm 3) – Phase 2: Spleen volume response: ≥35% spleen volume reduction (SVR35) at any time.
Endpoint(s): Nuvisertib Monotherapy (Arm 1) - Phase 1 and 2: Spleen volume response: - ≥ 25% spleen volume reduction [SVR25] at any time; - Duration of spleen volume response., Nuvisertib Monotherapy (Arm 1) - Phase 1 and 2: Total symptom score response assessed by MFSAF v4.0; - ≥ 50% improvement in total symptom score (TSS50) at Week 24; - Duration of TSS50 over time during the study; - Absolute TSS change from baseline at Week 24., Nuvisertib Monotherapy (Arm 1) - Phase 1 and 2: Patient Global Impression of Change (PGIC) at Week 24 and at any time., Nuvisertib Monotherapy (Arm 1) - Phase 1 and 2: Response evaluation per the revised IWG-MRT criteria: Complete remission (CR), partial remission (PR), clinical improvement (CI), stable disease (SD), and progressive disease (PD)., Nuvisertib Monotherapy (Arm 1) - Phase 1 and 2: QT interval changes., Nuvisertib Monotherapy (Arm 1) - Phase 1 and 2: PK parameters of Nuvisertib: Cmax, tmax, AUC, t½, and others as data permits., Nuvisertib + Momelotinib (Arm 3) – Phase 1 and 2: Spleen volume response: - ≥25% spleen volume reduction [SVR25] at any time; - Duration of spleen volume response., Nuvisertib + Momelotinib (Arm 3) – Phase 1 and 2: Total symptom score response assessed by MFSAF v4.0: - ≥ 50% improvement in total symptom score (TSS50) at Week 24; - Duration of TSS50 over time during the study; - Absolute TSS change from baseline at Week 24., Nuvisertib + Momelotinib (Arm 3) – Phase 1 and 2: Patient Global Impression of Change (PGIC) at Week 24 and at any time., Nuvisertib + Momelotinib (Arm 3) – Phase 1 and 2: Response evaluation per the revised IWG-MRT criteria: - Complete remission (CR), partial remission (PR), clinical improvement (CI), stable disease (SD), and progressive disease (PD)., Nuvisertib + Momelotinib (Arm 3) – Phase 1 and 2: PK parameters of TP-3654 and momelotinib: Cmax, tmax, AUC, t½ and others as data permits.

Source: https://euclinicaltrials.eu/ctis-public/view/2022-502597-16-00